EU clinical trial 2025-520771-59-00: An Extension Study to Evaluate the Long-Term Safety and Efficacy of Afimkibart (RO7790121) in Patients with Atopic Dermatitis who Participated in Previous Afimkibart Clinical Trials
Protocol code: CS45943
Sponsor: F. Hoffmann-La Roche AG (Pharmaceutical company). Phase: Therapeutic exploratory (Phase II). Countries: Italy (ongoing, recruiting), Poland (ongoing, recruiting), Germany (ongoing, recruiting), Spain (ongoing, recruiting), France (authorised, recruitment pending).
Therapeutic area(s): Diseases [C] - Skin and Connective Tissue Diseases [C17]; Phenomena and Processes [G] - Immune System Phenomena [G13]
Gender: Female, Male. Age: 18-64 years, 65+ years. Enrolment: 49.
Start date (EU): 2026-02-03. Decision date: 2025-11-13. Results received: No. Last updated: 2026-02-18.
Decision dates by country: DE: 2025-11-13, IT: 2025-11-20, ES: 2025-11-17, PL: 2025-11-21, FR: 2026-01-30

Condition(s): Atopic Dermatitis
Product: RO7790121, RO7790121 placebo/diluent

Primary endpoint: Incidence and severity of adverse events, serious adverse events, adverse events leading to study treatment discontinuation, adverse events of special interest
Endpoint(s): Change and percent change from baseline (in parent study) in Eczema Area and Severity Index (EASI) score at each visit, Proportion of participants with EASI50/75/90 at each visit, Proportion of participants achieving a Validated Investigator Global Assessment Scale for Atopic Dermatitis (vIGA-AD) of clear (0) or almost clear (1) with more than or equal to 2-grade improvement from baseline (in the parent study) at each visit, Change from parent baseline (in the parent study) in Participant-Oriented Eczema Measure (POEM) at each visit, Change from parent baseline (in the parent study) in Dermatology Life Quality Index (DLQI) at each visit, Change from baseline (in the parent study) in selected clinical laboratory test results, Change from baseline in selected vital signs, Serum concentration of afimkibart at specified timepoints, Incidence and titres of ADA and NAb

Source: https://euclinicaltrials.eu/ctis-public/view/2025-520771-59-00